EU clinical trial 2024-519088-16-01: GRoningen Early-PD Ambroxol Treatment Pharmacokinetics
Protocol code: GREAT-PK
Sponsor: Universitair Medisch Centrum Groningen (Hospital/Clinic/Other health care facility). Phase: Human Pharmacology (Phase I)- Other. Countries: Netherlands (authorised, recruitment pending).
Therapeutic area(s): Diseases [C] - Nervous System Diseases [C10]
Gender: Female, Male. Age: 18-64 years, 65+ years. Enrolment: 15.
Status: Authorised, recruitment pending. Decision date: 2025-07-16. Results received: No. Last updated: 2025-07-16.

Condition(s): Parkinson's disease

Source: https://euclinicaltrials.eu/ctis-public/view/2024-519088-16-01